EU clinical trial 2023-504208-27-00: CUSTOMIZED ANTIBIOTIC TREATMENT DURATION AMONG HOSPITALIZED PATIENTS WITH MODERATELY SEVERE COMMUNITY-ACQUIRED PNEUMONIA [CAT-CAP]
Protocol code: APHP220814
Sponsor: Assistance Publique Hopitaux De Paris (Hospital/Clinic/Other health care facility). Phase: Therapeutic confirmatory (Phase III). Countries: France (ongoing, recruiting).
Therapeutic area(s): Diseases [C] - Bacterial Infections and Mycoses [C01]
Gender: Female, Male. Age: 18-64 years, 65+ years. Enrolment: 424.
Status: Ongoing, recruiting. Start date (EU): 2024-02-12. Decision date: 2023-12-15. Results received: No. Last updated: 2025-04-10.

Condition(s): Community-acquired pneumonia
Product: PRISTINAMYCIN, AMOXICILLIN, CEFTRIAXONE, LEVOFLOXACIN, AMOXICILLIN AND BETA-LACTAMASE INHIBITOR, CEFOTAXIME PANPHARMA 1 g, poudre pour solution injectable (IM-IV)

Primary endpoint: Rate of cure at Day 15 after treatment initiation Cure at Day 15 will be defined by the association of: 1.Persistence of stability criteria (body temperature ≤ 37.8°C; heart rate ≤ 100/min; systolic blood pressure > 90mmHg; oxygen saturation ≥ 92%; respiratory rate < 24/min; normal mental status); 2.No additional antibiotic treatment, targeting CAP, taken after the end of initial antibiotic treatment. Patients dead or not cured as defined above, will be classified as failure at Day 15.
Endpoint(s): Rate of cure at Day 30 after the start of treatment defined by the association of: persistence of stability criteria (body temperature ≤ 37.8°C; heart rate ≤ 100/min; systolic blood pressure > 90mmHg; O2 saturation ≥ 90% on room air; respiratory rate < 24/min; normal mental status); absence of additional antibiotic treatment needed after the end of initial antibiotic treatment ((except for oral fosfomycin, furadantin and pivmecillinam)., All-cause mortality on Day 30 after the start of antibiotic treatmen, Patients' evolution of pneumonia symptoms and quality of life (CAP Score / CAP Sym) at Day 0 of treatment (retrospectively), at stability (Day S), at Day 7, at Day 15, and at Day 30 of antibiotic treatment;, Duration of antibiotic treatment targeting CAP during the 30 days after the start of treatment;, Duration of antibiotic treatment for all indications during the 30 days after the start of treatment, Length of initial hospital stay, Frequency and severity of adverse events during the 30 days after the start of treatment., Analysis of microbiome and resistance genes at Day S and Day 30

Source: https://euclinicaltrials.eu/ctis-public/view/2023-504208-27-00